EU clinical trial 2025-521872-69-00: OMTX705-006 Phase 1b
Protocol code: OMTX705-006
Sponsor: Oncomatryx Biopharma S.A. (Pharmaceutical company). Phase: Human Pharmacology (Phase I)- Other. Countries: Spain (ongoing, recruiting).
Therapeutic area(s): Diseases [C] - Neoplasms [C04]
Gender: Female, Male. Age: 18-64 years, 65+ years. Enrolment: 54.
Status: Ongoing, recruiting. Start date (EU): 2025-10-28. Decision date: 2025-09-01. Results received: No. Last updated: 2026-02-11.
Decision dates by country: ES: 2025-10-24

Condition(s): Advanced/Metastatic Pancreatic Adenocarcinoma

Source: https://euclinicaltrials.eu/ctis-public/view/2025-521872-69-00